EU clinical trial 2025-521437-88-00: A phase II study of ficerafusp alfa (BCA 101) in combination with nivolumab in platinum refractory head and neck squamous cell carcinoma patients who progressed within 6 months after multimodal treatment for locally advanced disease ( BICARA)
Protocol code: GORTEC 2025-01
Sponsor: Groupe Oncologie Radiotherapie Tete Cou (Patient organisation/association). Phase: Therapeutic exploratory (Phase II). Countries: France (ongoing, recruiting).
Therapeutic area(s): Diseases [C] - Neoplasms [C04]
Gender: Female, Male. Age: 18-64 years, 65+ years. Enrolment: 121.
Status: Ongoing, recruiting. Start date (EU): 2026-07-03. Decision date: 2026-03-02. Results received: No. Last updated: 2026-03-02.

Condition(s): head and neck squamous cell carcinoma
Product: Ficerafusp Alfa, OPDIVO 10 mg/mL concentrate for solution for infusion.

Primary endpoint: objective response rate (ORR) which is defined as the proportion of patients with a confirmed best overall response (BOR) complete response (CR) or partial response (PR) as determined by the investigator according to RECIST criteria 1.1
Endpoint(s): Duration of objective response (DOR) is defined as the time (months) between first occurrence of CR or PR to disease progression or death, whichever comes first. Only those patients with confirmed objective responses of CR or PR will be included in this analysis. Censoring rules for patients who do not experience progression (PD) or death will be described in the SAP, Progression-free survival (PFS) is defined as the time (months) from randomization (or start of treatment in the run-in phase) to the first radiographic documentation of objective progression as assessed by the investigator using RECIST v1.1, or death from any cause, whichever comes first. Censoring rules for patients who do not experience PD or death will be described in the SAP, Overall survival (OS) is defined as the time (months) between randomization (or start of treatment in the run-in phase) and death of any cause or date of last FU for patients alive, Incidence and severity of adverse events, serious adverse events and laboratory abnormalities as graded by the National Cancer Institute - Common Terminology Criteria of Adverse Events (NCI-CTCAE) v 5.0

Source: https://euclinicaltrials.eu/ctis-public/view/2025-521437-88-00